EU clinical trial 2023-510185-27-00: Sequential neoadjuvant ifosfamide and doxorubicin in localized high-grade soft tissue sarcoma of extremities and trunk wall
Sponsor: Oslo University Hospital HF (Hospital/Clinic/Other health care facility). Phase: Therapeutic exploratory (Phase II). Countries: Norway (ongoing, recruiting).
Therapeutic area(s): Diseases [C] - Neoplasms [C04]
Gender: Female, Male. Age: 18-64 years, 65+ years. Enrolment: 50.
Status: Ongoing, recruiting. Start date (EU): 2021-03-01. Decision date: 2024-11-07. Results received: No. Last updated: 2026-05-15.

Condition(s): Patients with high-grade soft tissue sarcoma of the extremities and trunk wall
Product: Adriamycin 2 mg/ml injeksjonsvæske, oppløsning, Holoxan 1000 mg pulver til injeksjonsvæske/infusjonsvæske, oppløsning

Primary endpoint: Overall response rate (ORR), defined as partial or complete response as assessed by RECIST 1.1.
Endpoint(s): Diseasefree survival and overall survival, Overall response rate defined as partial or complete response, Adverse event, serious adverse event and dose reductions or discontinuation due to toxicity., Change from baseline in EORTC QLQ-C30 scores.

Source: https://euclinicaltrials.eu/ctis-public/view/2023-510185-27-00